EU clinical trial 2025-521671-31-00: A Phase 1b/2 Study to Investigate the Safety, Efficacy and Pharmacokinetics of Administration of Subcutaneous (SC) Blinatumomab in Pediatric Participants with Relapsed/Refractory (R/R) and Minimal Residual Disease Positive (MRD+) B Cell Precursor Acute Lymphoblastic Leukemia (B-ALL)
Protocol code: 20220107
Sponsor: Amgen Inc. (Pharmaceutical company). Phase: Phase I and Phase II (Integrated)- Other. Countries: France (authorised, recruitment pending), Netherlands (authorised, recruitment pending), Italy (authorised, recruitment pending).
Therapeutic area(s): Diseases [C] - Neoplasms [C04]
Gender: Female, Male. Age: 0-17 years. Enrolment: 6.
Status: Authorised, recruitment pending. Decision date: 2026-02-13. Results received: No. Last updated: 2026-04-29.
Decision dates by country: NL: 2026-02-17, IT: 2026-02-13, FR: 2026-02-13

Condition(s): Relapsed/Refractory (R/R) and Minimal Residual Disease Positive (MRD+) B-Cell Precursor Acute Lymphoblastic Leukemia
Product: Blinatumomab SC2

Primary endpoint: Phase 1b: Dose limiting toxicities (DLTs), treatment-emergent adverse events (TEAE), serious TEAE, treatment related TEAE, and adverse events of interest (EOI), Phase 2 R/R B-ALL (Cohort Ph2-R): CR/CRh within the first 2 cycles, Phase 2 MRD+ B-ALL (Cohort Ph2-M): CR with MRD negative response (MRD <10-4 [0.01%]) within the first 2 cycles
Endpoint(s): Phase 1b: Complete remission/complete remission with partial hematological recovery (CR/CRh) within the first 2 cycles, Phase 1b: CR within the first 2 cycles, Phase 1b: CR/CRh/CRi/Blast free hypoplastic or aplastic BM within the first 2 cycles, Phase 1b: MRD negative response (MRD level < 10-4 [0.01%]) within the first 2 cycles, Phase 1b: DOR is defined as the time from the first response of CR/CRh within the first 2 cycles until hematological relapse (Including EM relapse) per investigator’s assessment or death due to any cause, whichever occurs first, Phase 1b: PK parameters following SC blinatumomab administration including, but not limited to, maximum concentration (Cmax), time to maximum concentration (Tmax), and area under the concentration time curve (AUC), Phase 1b: Incidence of anti-blinatumomab antibody formation, Phase 2 (Cohort Ph2-R) Key Secondary: CR/CRh with MRD negative response (MRD < 10-4 [0.01%]) within the first 2 cycles, Phase 2 (Cohort Ph2-R) Key Secondary: DOR is defined as the time from the first response of CR/CRh within the first 2 cycles until hematological relapse (Including EM relapse) per investigator’s assessment or death due to any cause, whichever occurs first, Phase 2 (Cohort Ph2-R): CR within the first 2 cycles, Phase 2 (Cohort Ph2-R): CR/CRh/CRi/Blast free hypoplastic or aplastic BM within the first 2 cycles, Phase 2 (Cohort Ph2-R): OS is defined as the time from the first dose until death due to any cause, Phase 2 (Cohort Ph2-R): Incidence of TEAE, serious TEAE, Treatment related TEAE, and EOI, Phase 2 (Cohort Ph2-R): Blinatumomab PK serum concentrations, Phase 2 (Cohort Ph2-R): Incidence of anti-blinatumomab antibody formation, Phase 2 (Cohort Ph2-M) Key Secondary: CR/CRh with MRD negative response (MRD < 10-4 [0.01%]) within the first 2 cycles, Phase 2 (Cohort Ph2-M) Key Secondary: DOR is defined as the time from the first response CR with MRD negative response (MRD < 10-4 [0.01%]) within the first 2 cycles until hematological relapse (including EM relapse) or MRD relapse (MRD ≥ 10-4 [0.01%]) per investigator’s assessment or death due to any cause, whichever occurs first, Phase 2 (Cohort Ph2-M): CR/CRh/CRi/Blast free hypoplastic or aplastic BM with MRD negative response (MRD < 10-4 [0.01%]) within the first 2 cycles, Phase 2 (Cohort Ph2-M): OS, defined as the time of the start of first dose of SC blinatumomab until death due to any cause, Phase 2 (Cohort Ph2-M): Incidence of TEAE, serious TEAE, Treatment related TEAE, and EOI, Phase 2 (Cohort Ph2-M): Blinatumomab PK serum concentrations, Phase 2 (Cohort Ph2-M): Incidence of anti-blinatumomab antibody formation

Source: https://euclinicaltrials.eu/ctis-public/view/2025-521671-31-00